EU clinical trial 2024-519268-41-00: BEAT Fatigue – Benefit of Elevated Administration of Thiamine for Fatigue in Rheumatoid Arthritis: A randomized, double-blind, placebo-controlled trial
Sponsor: Odense University Hospital (Hospital/Clinic/Other health care facility). Phase: Therapeutic use (Phase IV). Countries: Denmark (authorised, recruitment pending).
Therapeutic area(s): Diseases [C] - Musculoskeletal Diseases [C05]; Phenomena and Processes [G] - Musculoskeletal and Neural Physiological Phenomena [G11]
Gender: Female, Male. Age: 18-64 years, 65+ years. Enrolment: 150.
Status: Authorised, recruitment pending. Decision date: 2026-06-12. Results received: No. Last updated: 2026-06-12.

Condition(s): Fatigue in rheumatoid arthritis patients
Product: Placebo (matching Tablets), APOVIT B1 vitamin ekstra stærk, tabletter 300 mg

Primary endpoint: The difference in least squares mean changes in the BRAF-MDQ global score from baseline to 4 weeks.
Endpoint(s): Changes from baseline to week 4 in the specific domains assessed by the BRAF-MDQ including Physical Fatigue, Living Fatigue, Cognitive Fatigue, and Emotional Fatigue, Changes in BRAF-NRS Severity scale, BRAF-NRS Effect scale, BRAF-NRS Coping scale from baseline to week 4., Number of (1) swollen out of 28 and (2) tender joints out of 28, (3) pain (assessed through a visual analogue scale [VAS] ranging from 0-100 where higher numbers indicates worse pain), (4) physical disability (assessed by the Health Assessment Questionnaire [HAQ]), (5) patient- and (6) doctors global assessment (assessed through a VAS ranging from 0-100 where higher numbers indicates worse assessment), and finally (7) acute phase reactants will be evaluated based on the C-reactive protein., Proportion of patients achieving a 20%, 50%, and 70% reduction in BRAF-MDQ after 4 weeks of treatment, Changes from baseline to week 4 according to the EQ-5D-5L questionnaire

Source: https://euclinicaltrials.eu/ctis-public/view/2024-519268-41-00